EU clinical trial 2026-525625-21-00: A clinical trial of MK-6050 in healthy participants (MK-6050-002)
Protocol code: MK-6050-002
Sponsor: Merck Sharp & Dohme LLC (Pharmaceutical company). Phase: Human Pharmacology (Phase I)- Other. Countries: Belgium (ongoing, recruiting).
Therapeutic area(s): Diseases [C] - Immune System Diseases [C20]
Gender: Female, Male. Age: 18-64 years. Enrolment: 52.
Status: Ongoing, recruiting. Start date (EU): 2026-04-28. Decision date: 2026-04-13. Results received: No. Last updated: 2026-04-13.

Condition(s): Hidradenitis suppurativa

Source: https://euclinicaltrials.eu/ctis-public/view/2026-525625-21-00